EU clinical trial 2024-519472-69-00: Multicenter prospective trial after first or second unsuccessful treatment discontinuation in chronic myeloid leukemia estimating the efficacy of nilotinib in inducing the persistence of molecular remission after stopping TKI 2nd or 3rd time
Protocol code: CAMN107ADE22T
Sponsor: Heidelberg University (Educational Institution). Phase: Therapeutic exploratory (Phase II). Countries: Germany (authorised, recruitment pending).
Therapeutic area(s): Not possible to specify; Diseases [C] - Hemic and Lymphatic Diseases [C15]; Diseases [C] - Neoplasms [C04]
Gender: Female, Male. Age: 18-64 years, 65+ years. Enrolment: 75.
Status: Authorised, recruitment pending. Decision date: 2024-11-27. Results received: No. Last updated: 2024-11-27.

Condition(s): CML-Patients in chronic phase having failed a prior attempt to stop imatinib or other TKIs therapy either within EURO-SKI or not and are pretreated at least one year with any TKI after 1st stop
Product: Tasigna 150 mg hard capsules

Primary endpoint: The primary endpoint is molecular relapse-free survival, measured at 12 months and 36 months after 2nd or 3rd stop.
Endpoint(s): overall survival and progression-free survival probabilities, Estimation of the number of patients in MR4.5 who would be eligible for stopping TKI therapy, The number of patients who regain MR4 and MR4.5 and the time to MR4 recovery, Outcome of molecular relapse-free survival at 12, 18, 24 and 36 months after TKI discontinuation

Source: https://euclinicaltrials.eu/ctis-public/view/2024-519472-69-00